EU clinical trial 2025-524322-18-00: A Phase 3, Randomized, Double-blind, Efficacy and Safety Study Comparing Orelabrutinib to Placebo in Patients With Non-Active Secondary Progressive Multiple Sclerosis
Protocol code: ZB020-03-002
Sponsor: Zenas Biopharma (USA) LLC (Pharmaceutical company). Phase: Therapeutic confirmatory (Phase III). Countries: Germany (authorised, recruitment pending), Bulgaria (authorised, recruitment pending), Netherlands (authorised, recruitment pending), Sweden (authorised, recruitment pending), Portugal (authorised, recruitment pending), Croatia (authorised, recruitment pending), Italy (authorised, recruitment pending), Austria (authorised, recruitment pending), Spain (authorised, recruitment pending), Poland (authorised, recruiting), France (authorised, recruitment pending), Denmark (authorised, recruitment pending), Hungary (authorised, recruitment pending), Romania (authorised, recruitment pending), Estonia (authorised, recruitment pending), Slovakia (authorised, recruitment pending), Belgium (authorised, recruitment pending), Czechia (authorised, recruitment pending), Norway (authorised, recruitment pending), Lithuania (authorised, recruitment pending), Greece (authorised, recruitment pending).
Therapeutic area(s): Diseases [C] - Nervous System Diseases [C10]
Gender: Female, Male. Age: 18-64 years. Enrolment: 467.
Start date (EU): 2026-07-22. Decision date: 2026-06-22. Results received: No. Last updated: 2026-08-03.
Decision dates by country: AT: 2026-06-29, BE: 2026-06-23, BG: 2026-06-24, HR: 2026-06-26, DK: 2026-06-23, EE: 2026-06-29, FR: 2026-06-22, DE: 2026-06-24, GR: 2026-06-23, HU: 2026-06-26, IT: 2026-06-23, LT: 2026-06-23, PT: 2026-06-26, RO: 2026-06-29, ES: 2026-06-29, NO: 2026-06-22, PL: 2026-06-29, SK: 2026-06-23, CZ: 2026-07-30, NL: 2026-06-23, SE: 2026-06-24

Condition(s): Non-active Secondary Progressive Multiple Sclerosis (SPMS)
Product: Placebo tablets match with that of orelabrutinib (ICP-022) tablets in appearance, shape, size, and weight., Orelabrutinib

Primary endpoint: Time to onset of confirmed disability progression (CDP) events, confirmed over at least 24 weeks (24-week CDP).
Endpoint(s): 1) Time to onset of CDP events on EDSS, confirmed over at least 12 weeks (12-week CDP), 2) The total number of new or enlarging T2 lesions on MRI scans of the brain

Source: https://euclinicaltrials.eu/ctis-public/view/2025-524322-18-00